EU clinical trial 2023-509259-15-01: Optimizing metformin use in polycystic ovary syndrome - A randomized controlled trial
Sponsor: HUS-yhtymae (Hospital/Clinic/Other health care facility). Phase: Therapeutic use (Phase IV). Countries: Finland (authorised, recruitment pending).
Therapeutic area(s): Diseases [C] - Hormonal diseases [C19]; Phenomena and Processes [G] - Metabolism [G03]
Gender: Female. Age: 18-64 years. Enrolment: 184.
Status: Authorised, recruitment pending. Decision date: 2025-02-06. Results received: No. Last updated: 2025-02-09.
Decision dates by country: FI: 2025-02-09

Condition(s): Polycystic ovary syndrome
Product: METFORMIN, METFORMIN HYDROCHLORIDE

Primary endpoint: Anthropometrics (weight), Androgenicity (hirsutism and testosterone), Metabolic (HOMA-IR), Gastrointestinal side-effects (nausea, vomiting, abdominal pain), Polycystic ovary morphology: AMH
Endpoint(s): Androgenicity: FAI, SHBG, DHEAS, androstenedione, free testosterone, acne and alopecia, Menstrual cyclicity (questionnaire where asking how long the two previous cycles were (days), Quality of life and weight stigma: anxiety, weight stigma, Metabolic: fasting glucose, fasting insulin, HbA1C, lipids, CRP, ALAT, GGT, OGTT, FLI, Matsuda Index, TyG index, Polycystic ovary morphology: ultrasound (follicle number per ovary, ovarian volume), Anthropometric (BMI, waist-hip-ratio, WC, BAI, body composition, bloodpressure, pulse)

Source: https://euclinicaltrials.eu/ctis-public/view/2023-509259-15-01